EU clinical trial 2025-525040-18-00: DECREASE-IPC 2025-068 : De-Ecalating neoadjuvant Chemoimmunotherapy in early triple-negative BREASt cancer
Protocol code: IPC 2025-068
Sponsor: Institut Paoli Calmettes (Hospital/Clinic/Other health care facility). Phase: Therapeutic exploratory (Phase II). Countries: France (authorised, recruitment pending).
Therapeutic area(s): Diseases [C] - Neoplasms [C04]
Gender: Female, Male. Age: 18-64 years, 65+ years. Enrolment: 84.
Status: Authorised, recruitment pending. Decision date: 2026-07-24. Results received: No. Last updated: 2026-07-24.

Condition(s): triple‑negative breast cancer
Product: PACLITAXEL HOSPIRA 6 mg/mL, solution for dilution for infusion, CARBOPLATINE ACCORD 10 mg/ml, solution pour perfusion, KEYTRUDA 25 mg/mL concentrate for solution for infusion., Endoxan, DOXORUBICINE ARROW 2 mg/ml, solution pour perfusion, EPIRUBICINE MEDAC 2 mg/ml, solution pour perfusion

Primary endpoint: The primary endpoint is the percentage of patients with no suspected residual tumor on breast MRI and biopsy after 12 weeks of neoadjuvant treatment, confirmed by histological analysis of the surgical specimen (breast tumor and axillary lymph nodes), corresponding to ypT0/Tis ypN0 according to the AJCC 8th edition classification
Endpoint(s): Event‑free survival (EFS), which will be calculated as the time from inclusion to the occurrence of one of the following events: disease progression preventing surgery, local or distant recurrence, second primary cancer (breast or other), or death from any cause, Overall survival, which will be calculated from the date of inclusion to the date of death from any cause., Residual cancer burden (RCB), which will be calculated as a continuous index combining pathological measurements of the primary tumor (size and cellularity) and nodal metastases (number and size), according to the definition by Symmans et al. (28). RCB‑0 is defined as a pathological complete response (pCR, ypT0/Tis ypN0). RCB‑1 corresponds to minimal residual disease, RCB‑2 to moderate residual disease, and RCB‑3 to extensive residual disease, Toxicity related to chemotherapy and immunotherapy, which will be assessed by the presence and grade of adverse events of interest related to chemotherapy and pembrolizumab immunotherapy, Quality of life, which will be assessed using the EORTC QLQ‑C30 self‑questionnaire (at inclusion, before surgery, and 3 months after surgery) and the EQ‑5D‑5L (at each follow‑up visit for 3 years), Fear of recurrence, which will be assessed using the French version of the FCRI‑SF (Fear of Cancer Recurrence Inventory – Short Form) including 9 items, at inclusion, before surgery, and at each post‑treatment follow‑up visit for 3 years, Complete response assessed on MRI, which will be compared with RCB‑0, RCB‑1, and RCB‑2‑3 rates, The pre‑treatment TIL percentage (continuous and dichotomous variable) will be estimated and compared across RCB‑0, RCB‑1, and RCB‑2‑3 rates; TILs will be assessed according to the recommendations of the 2014 International TILs Working Group, The exploratory endpoints are the identification and characterization of biomarkers through specific biological analyses including RNA expression profiling, spatial transcriptomic and proteomic analyses, and immunomonitoring

Source: https://euclinicaltrials.eu/ctis-public/view/2025-525040-18-00